EU clinical trial 2025-523100-77-00: C5041018 - A Phase 2 Open-Label, Single Arm Study to Evaluate the Efficacy, Pharmacokinetics, and Safety of Etrasimod in Pediatric Participants with Moderately to Severely Active Ulcerative Colitis
Protocol code: C5041018
Sponsor: Pfizer Inc. (Pharmaceutical company). Phase: Therapeutic exploratory (Phase II). Countries: Finland (ended), Poland (ongoing, recruiting), France (authorised, recruitment pending), Germany (authorised, recruiting), Italy (authorised, recruiting), Slovakia (ended).
Therapeutic area(s): Diseases [C] - Digestive System Diseases [C06]
Gender: Female, Male. Age: 0-17 years. Enrolment: 14.
Start date (EU): 2026-04-23. Decision date: 2026-02-27. Results received: No. Last updated: 2026-04-08.
Decision dates by country: DE: 2026-03-02, IT: 2026-03-02, PL: 2026-03-07, SK: 2026-03-03, FR: 2026-02-27, FI: 2026-03-02

Condition(s): Ulcerative Colitis
Product: PF-07915503, PF-07915503, PF-07915503, Etrasimod Arginine Blue, PF-07915503

Primary endpoint: Clinical remission based on modified Mayo score (MMS) at Week 52
Endpoint(s): Clinical remission based on MMS at Week 12. Other secondary endpoints based on MMS score components, individually assessed at Week 12 and Week 52: •Clinical response •Endoscopic improvement •Corticosteroid-free remission endpoint Symptomatic remission at all time points up to Week 52 Pediatric Ulcerative Colitis Activity Index (PUCAI) clinical remission PUCAI clinical response, Incidence and severity of adverse events, including serious adverse events (SAEs) and adverse events (AEs) leading to discontinuation Incidence and severity of laboratory abnormalities. Incidence of clinically significant vital sign abnormalities. Development and maturation assessment: change from baseline in z-scores height and weight, Tanner stage, Response to taste acceptability/palatability questionnaire on etrasimod tablets and granules, Etrasimod plasma concentrations

Source: https://euclinicaltrials.eu/ctis-public/view/2025-523100-77-00